EU clinical trial 2024-516181-11-00: VALYM - A phase II open-label study evaluating valemetostat tosylate as a single agent in patients with relapse/refractory B-cell lymphoma
Protocol code: VALYM
Sponsor: LYSARC (Laboratory/Research/Testing facility). Phase: Therapeutic exploratory (Phase II). Countries: France (ongoing, recruiting), Belgium (ongoing, recruiting).
Therapeutic area(s): Diseases [C] - Hemic and Lymphatic Diseases [C15]
Gender: Female, Male. Age: 18-64 years, 65+ years. Enrolment: 140.
Status: Ongoing, recruiting. Start date (EU): 2021-06-10. Decision date: 2024-09-13. Results received: No. Last updated: 2025-12-15.
Decision dates by country: BE: 2024-09-16, FR: 2024-09-13

Condition(s): RELAPSE/REFRACTORY B-CELL LYMPHOMA.
Product: Valemetostat Tosylate, Valemetostat Tosylate

Primary endpoint: overall response rate (ORR) defined as the proportion of subjects achieving best overall response of partial response (PR) or complete response (CR) at any time, according to the Lugano 2014 classification (PET-CT–Based Response for FDG-avid lymphomas or CT-Based Response if not) and determined by investigator.
Endpoint(s): - Rate of complete response (CR), - Progression-free survival (PFS), - Duration of response (DOR), - Time to response (TTR), - Safety

Source: https://euclinicaltrials.eu/ctis-public/view/2024-516181-11-00